EU clinical trial 2023-503509-12-00: Model-informed precision dosing during infliximab rescue therapy for patients with steroid-refractory acute severe ulcerative colitis: an exploratory study
Sponsor: UZ Leuven (Hospital/Clinic/Other health care facility). Phase: Therapeutic use (Phase IV). Countries: Belgium (ongoing, recruiting).
Therapeutic area(s): Diseases [C] - Digestive System Diseases [C06]; Diseases [C] - Immune System Diseases [C20]
Gender: Female, Male. Age: 18-64 years, 65+ years. Enrolment: 13.
Status: Ongoing, recruiting. Start date (EU): 2025-09-01. Decision date: 2024-12-18. Results received: No. Last updated: 2024-12-18.

Condition(s): Acute severe ulcerative colitis
Product: Inflectra 100 mg powder for concentrate for solution for infusion

Primary endpoint: A description of the workload experienced by the healthcare personnel involved in the MIPD process, using the National Aeronautics and Space Association task load index (NASA-TLX, cf. Appendix 1). [feasibility], A relative bias (rBias) within 20% between observation and model prediction, with a 95% confidence interval including zero. [performance]
Endpoint(s): colectomy-free survival at 12 weeks (± one week) after start of infliximab therapy (short- term);, colectomy-free survival at 24 weeks (± one week) (i.e., the end of the safety follow-up) ;, (steroid-free) clinical response at 12 weeks (± one week) after start of infliximab therapy (short-term);, (steroid-free) clinical remission at 12 weeks (± one week) after start of infliximab therapy (short-term);, biological response at 12 weeks (± one week) after start of infliximab therapy (short-term);, biological remission at 12 weeks (± one week) after start of infliximab therapy (short-term);, endoscopic response at 12 weeks (± one week) after start of infliximab therapy (short-term);, endoscopic remission at 12 weeks (± one week) after start of infliximab therapy (short- term);, minimal histological disease activity at 12 weeks (± one week) after start of infliximab therapy (short-term);, intestinal ultrasound (IUS) based disease activity during the first 12 weeks after the start of infliximab therapy (short-term), histological remission at 12 weeks (± one week) after start of infliximab therapy (short-term), percentage of target concentration attainment during the first 12 weeks;, length of hospital admission after start of infliximab therapy;, mortality;, relapse-free survival in patients achieving clinical remission;, need for rescue therapy other than infliximab;, postoperative complications;, the total infliximab dose, the number of infliximab infusions, and the direct cost of infliximab therapy during the first 12 weeks (± one week) of the model-guided infliximab rescue therapy., the ratio of the direct cost to the proportion of patients achieving colectomy-free survival at week 12 (± one week) after the start of model-guided infliximab rescue therapy

Source: https://euclinicaltrials.eu/ctis-public/view/2023-503509-12-00